EU clinical trial 2022-502972-22-00: A Randomized, Double-Blind, Placebo-Controlled Phase 3 Study of VE303 for Prevention of Recurrent Clostridioides difficile Infection: The RestoratiVE303 Study
Protocol code: VE303-003
Sponsor: Vedanta Biosciences Inc. (Pharmaceutical company). Phase: Therapeutic confirmatory (Phase III). Countries: Netherlands (ongoing, recruiting), Belgium (ongoing, recruiting), Italy (ongoing, recruiting), Portugal (ended), Poland (ended), Ireland (ended), Romania (ongoing, recruiting), Spain (ongoing, recruiting), France (ongoing, recruiting), Czechia (ended), Germany (ongoing, recruiting), Bulgaria (ongoing, recruiting), Hungary (ongoing, recruiting), Denmark (ongoing, recruiting).
Therapeutic area(s): Diseases [C] - Bacterial Infections and Mycoses [C01]
Gender: Female, Male. Age: 0-17 years, 18-64 years, 65+ years. Enrolment: 156.
Start date (EU): 2024-10-31. Decision date: 2024-10-07. Results received: No. Last updated: 2026-07-22.
Decision dates by country: PL: 2024-10-13, PT: 2024-10-11, CZ: 2024-10-11, IE: 2024-10-11, HU: 2024-10-09, NL: 2024-10-10, RO: 2024-10-14, ES: 2024-10-08, DK: 2024-10-07, IT: 2024-10-09, BE: 2024-10-11, DE: 2024-10-10, BG: 2024-10-14, FR: 2024-10-09

Condition(s): Clostridioides difficile infection.
Product: Placebo capsules containing microcrystalline cellulose, visually identical to and not discernible from VE303 capsules. Placebo capsules do not contain any bacterial strains or formulation buffer used in the VE303 drug product.

Primary endpoint: Proportion of participants with central laboratory confirmed CDI recurrence through Week 8
Endpoint(s): Incidence and severity of treatment-emergent adverse events (TEAEs), treatment-related TEAEs, serious adverse events (SAEs), medically attended adverse events (MAAEs), and adverse events of special interest (AESIs) through week 8 and 248 (primary safety endpoint) and week 24, Proportion of participants with central laboratory confirmed CDI recurrence through Week 12 and Week 24, Fecal VE303 bacterial strain colonization detection, abundance and duration, Change from baseline in the the short-chain fatty acids (Cdiff32) score Change from baseline in EQ-5D score, utility index, and EuroQol Visual Analogue Scale ( EQ VAS ) score Change from baseline in CDI-Daily Symptoms ( CDI-DaySyms) daily symptoms score, Relationship between of VE303 strain colonization and CDI recurrence rate and time to recurrence.

Source: https://euclinicaltrials.eu/ctis-public/view/2022-502972-22-00